EU clinical trial 2024-511089-36-00: A 14-Week Phase 2b, RandomizEd, Double-BLind, Dose-Ranging Study to Determine the PharmacokInetics, Efficacy, Safety, and Tolerability of TEV-48574 in Adult PatiEnts with Moderate to Severe Ulcerative Colitis or Crohn’s Disease (RELIEVE UCCD)
Protocol code: TV48574-IMM-20036
Sponsor: Teva Branded Pharmaceutical Products R&D Inc. (Pharmaceutical company). Phase: Therapeutic exploratory (Phase II). Countries: Slovakia (ended), France (ended), Austria (ended), Bulgaria (ended), Hungary (ended), Norway (ended), Czechia (ended), Germany (ended), Italy (ended), Spain (ended), Belgium (ended), Poland (ended).
Therapeutic area(s): Diseases [C] - Digestive System Diseases [C06]
Gender: Female, Male. Age: 18-64 years, 65+ years. Enrolment: 214.
Status: Ended. Start date (EU): 2023-03-17. End date (EU): 2024-11-12. End date: 2024-11-13. Decision date: 2024-05-08. Results received: Yes. Last updated: 2024-12-09.
Decision dates by country: BE: 2024-05-14, FR: 2024-05-14, NO: 2024-05-10, HU: 2024-05-08, AT: 2024-05-12, CZ: 2024-05-10, IT: 2024-05-20, SK: 2024-05-10, ES: 2024-05-08, BG: 2024-05-10, DE: 2024-05-14, PL: 2024-05-16

Condition(s): Crohn’s disease, Ulcerative colitis
Product: TEV-48574, Placebo IMP for sc infusion is provided as a liquid solution in the same formulation as TEV-48574, except for the absence of active protein.

Primary endpoint: 1.Clinical remission is a modified (9-point rectal bleeding, stool frequency, and endoscopy) Mayo score of ≤2 points, which is defined by: stool frequency subscore of 0 or 1, rectal bleeding subscore of 0, and endoscopic subscore of 0 or 1, where a score of 1 does not include “friability”., 2. Endoscopic response defined as a reduction in Simple Endoscopic Score for Crohn’s Disease (SES CD) of at least 50% from baseline.
Endpoint(s): 1.In patients with moderate to severe UC: Clinical response at week 14, defined as a decrease from baseline in the modified (9-point rectal bleeding, stool frequency, and endoscopy) Mayo score of at least 2 points AND at least a 30% reduction from baseline with either a decrease in rectal bleeding subscore of at least 1 or an absolute rectal bleeding subscore of less than or equal to 1., 2. In patients with moderate to severe UC: Endoscopic improvement defined as a Mayo endoscopic subscore of 0 or 1 at week 14. Endoscopic remission defined as a Mayo endoscopic subscore of 0 at week 14. Clinical response defined as decrease from baseline of at least 50% in 2-item patient-reported outcome (PRO2; rectal bleeding and stool frequency) at week 14. Clinical remission defined as score of rectal bleeding = 0 and stool frequency = 0 on the PRO2 scale at week 14., 3.In patients with moderate to severe CD are as follows: Clinical response defined as a ≥100-point decrease in Crohn’s Disease Activity Index (CDAI) score from baseline at weeks 4, 8, 12 and 14. Clinical remission defined as a CDAI score <150 at week 14., 4.In patients with moderate to severe CD are as follows:-Clinical response defined as a decrease from baseline of at least 50% in PRO2 (PRO2 is defined as having 2 components, abdominal pain and stool frequency) at week 14., 5.In patients with moderate to severe CD are as follows: Clinical remission defined as abdominal pain ≤1 and stool frequency ≤3 on the PRO2 scale at week 14. Endoscopic response defined as a decrease in modified multiplier (MM)-SES-CD of >50% from baseline at week 14., 6. Safety and tolerability measures/parameters: Adverse events; Change from baseline in clinical laboratory test results (serum chemistry, hematology, and urinalysis)., 7. Safety and tolerability measures/parameters: Change from baseline in vital signs measurements (blood pressure, pulse rate, body temperature, and respiratory rate); Change from baseline in 12-lead electrocardiogram (ECG) findings; Patients who stopped the IMP due to adverse events; Local tolerability at the injection site., 8.Immunogenicity endpoints:-Change from baseline in treatment-emergent anti-drug antibody (ADA) at weeks 2, 4, 8, 14, and follow-up visit.-Presence of neutralizing ADA in ADA positive patients at weeks 2, 4, 8, 14, and follow-up visit.

Source: https://euclinicaltrials.eu/ctis-public/view/2024-511089-36-00